EU clinical trial 2024-511535-97-00: An Adaptive, Randomized, Placebo-controlled, Double-blind, Multi-center Study of Oral Etavopivat, a Pyruvate Kinase Activator in Patients with Sickle Cell Disease
Protocol code: 4202-HEM-301
Sponsor: Novo Nordisk A/S (Pharmaceutical company). Phase: Phase II and Phase III (Integrated). Countries: Germany (ongoing, recruitment ended), France (ongoing, recruitment ended), Italy (ongoing, recruitment ended), Spain (ongoing, recruitment ended), Greece (ongoing, recruitment ended).
Therapeutic area(s): Diseases [C] - Hemic and Lymphatic Diseases [C15]
Gender: Female, Male. Age: 0-17 years, 18-64 years, 65+ years. Enrolment: 94.
Status: Ongoing, recruitment ended. Start date (EU): 2021-12-16. Decision date: 2024-07-16. Results received: No. Last updated: 2026-04-23.
Decision dates by country: FR: 2024-07-23, DE: 2024-07-22, GR: 2024-10-01, IT: 2024-07-22, ES: 2024-07-16

Condition(s): sickle cell disease (SCD)
Product: Etavopivat A 100 mg, Etavopivat placebo., Etavopivat A 200 mg

Primary endpoint: • Hb response rate at Week 24 (increase of > 1 g/dL [> 10 g/L] from baseline) during the blinded treatment period, • Annualized VOC rate during the 52-week blinded treatment period based on adjudicated VOC review
Endpoint(s): 1. Change from baseline in Hb at Week 52 during the blinded treatment period, 2. Change in SCD-related clinical laboratory measurements from baseline at Week 24 during the blinded treatment period in: o Absolute reticulocyte count, o Indirect bilirubin, and o Lactate dehydrogenase (LDH), 3. Change from baseline in Patient-Reported Outcome Measurement Information System (PROMIS) Fatigue Scale in adult patients at Week 52 during the blinded treatment period, 4. Time to first VOC during the blinded treatment period

Source: https://euclinicaltrials.eu/ctis-public/view/2024-511535-97-00